EU clinical trial 2025-525097-11-00: Phase 3 Randomized Study of Teclistamab and Talquetamab (Tec-Tal) Versus Daratumumab and Lenalidomide (DR) in Minimal Residual Disease (MRD) Positive Patients With Newly Diagnosed Multiple Myeloma After Autologous Hematopoietic Stem Cell Transplantation (TiTan)
Protocol code: PMC011
Sponsor: Polish Myeloma Consortium (Patient organisation/association). Phase: Therapeutic confirmatory (Phase III). Countries: Poland (authorised, recruitment pending).
Therapeutic area(s): Diseases [C] - Hemic and Lymphatic Diseases [C15]
Gender: Female, Male. Age: 18-64 years, 65+ years. Enrolment: 248.
Status: Authorised, recruitment pending. Decision date: 2026-07-23. Results received: No. Last updated: 2026-07-23.

Condition(s): Multiple myeloma
Product: JNJ-64407564, DARZALEX 1800 mg solution for injection, Revlimid 15 mg hard capsules, JNJ-64407564, teclistamab, teclistamab

Primary endpoint: MRD-CR negativity (10^-5) with complete response at Month 12
Endpoint(s): Progression-free survival (PFS), Complete response (CR) or better, PFS2 (progression‑free survival to second disease progression or death), Overall survival (OS), Incidence and severity of AEs, Incidences of SAEs, MRD negativity (10^-5), Sustained MRD negativity (10^-5) for at least 12 months, • Time to worsening of symptoms • Mean change from baseline in the EORTC QLQ-C30 global health status and functional scale scores (including MY-20)

Source: https://euclinicaltrials.eu/ctis-public/view/2025-525097-11-00